EU clinical trial 2025-521870-33-00: Radioembolization with Intra-arterial Angiotensin II to improve Tumor-absorbed dose: The RADIANT study
Sponsor: Universitair Medisch Centrum Utrecht (Hospital/Clinic/Other health care facility). Phase: Therapeutic exploratory (Phase II). Countries: Netherlands (ongoing, recruiting).
Therapeutic area(s): Diseases [C] - Neoplasms [C04]; Diseases [C] - Digestive System Diseases [C06]
Gender: Female, Male. Age: 18-64 years, 65+ years. Enrolment: 15.
Status: Ongoing, recruiting. Start date (EU): 2026-01-05. Decision date: 2025-08-04. Results received: No. Last updated: 2025-11-04.

Condition(s): Liver cancer (primary or secondary)
Product: Giapreza 2.5 mg/ml concentrate for solution for infusion

Primary endpoint: TNR improvement factor: the TNR after AT-II infusion with subsequent direct 90Y microsphere injection as measured on 90Y PET/CT divided by the TNR after 99mTc-MAA without AT-II infusion as measured on SPECT/CT.
Endpoint(s): Toxicity profile of combining 90Y radioembolization with AT-II infusion (graded according to CTCAE v5.0), Technical success of AT-II infusion. Technical success is defined as the successful intra-arterial administration of AT-II (10 μg/min for 100 seconds) followed by immediate 90Y glass microsphere injection.

Source: https://euclinicaltrials.eu/ctis-public/view/2025-521870-33-00